EU clinical trial 2023-505536-35-00: Development of an optimized dosing regimen of ceftazidime-avibactam in critically ill patients treated with continuous renal replacement therapy
Sponsor: UZ Leuven (Hospital/Clinic/Other health care facility). Phase: Therapeutic use (Phase IV). Countries: Belgium (ongoing, recruiting), Sweden (authorised, recruiting), Spain (authorised, recruitment pending).
Therapeutic area(s): Diseases [C] - Bacterial Infections and Mycoses [C01]
Gender: Female, Male. Age: 18-64 years, 65+ years. Enrolment: 14.
Start date (EU): 2025-05-04. Decision date: 2025-01-24. Results received: No. Last updated: 2025-02-04.
Decision dates by country: BE: 2025-01-24, ES: 2025-02-04, SE: 2025-01-28

Condition(s): Ceftazidime-avibactam therapy in critically ill patients undergoing continuous renal replacement therapy
Product: CEFTAZIDIME AND BETA-LACTAMASE INHIBITOR

Primary endpoint: Pharmacokinetic parameters of ceftazidime and avibactam, PK/PD target attainment of ceftazidime and avibactam, Population PK model of ceftazidime-avibactam, Optimized ceftazidime-avibactam dosing regimen

Source: https://euclinicaltrials.eu/ctis-public/view/2023-505536-35-00